EU clinical trial 2023-504699-73-00: The evaluation of the effectiveness, safety and tolerability of treatment, using a specialized prostate-specific membrane antigen (PSMA) labeled with Lutetium177, in patients with recurrent and/or metastatic adenoid cystic carcinoma originating from the salivary glands - an open, non-commercial clinical trial
Protocol code: LuRM_ACC/2023
Sponsor: Narodowy Instytut Onkologii Im. Marii Sklodowskiej-Curie-Panstwowy Instytut Badawczy (Hospital/Clinic/Other health care facility). Phase: Therapeutic exploratory (Phase II). Countries: Poland (ended).
Therapeutic area(s): Diseases [C] - Neoplasms [C04]
Gender: Female, Male. Age: 18-64 years, 65+ years. Enrolment: 32.
Status: Ended. End date (EU): 2025-04-03. Decision date: 2023-09-04. Results received: No. Last updated: 2024-01-12.

Condition(s): Adenoid cystic carcinoma
Product: Pluvicto 1 000 MBq/mL solution for injection/infusion

Primary endpoint: Assessment of safety and tolerability of treatment according to Common Terminology Criteria for Adverse Events (CTCAE v. 5.0)
Endpoint(s): Objective response rate (ORR) – assessment in CT scan according to RECIST 1.1 score – 2 years after completion of the treatment, Progression free survival (PFS) - assessed from the start of treatment to the time of disease progression or death, Overall survival (OS) – assessed from the start of treatment to the time of death, Duration of response (DoR) – assessed from inclusion in the study to the time of progression or death in patients who achieved a complete or partial response - only patients in remission will have this parameter assessed, Quality of life assessment (according to EORTC QLQ-C30 and EORTC QLQ-H&N43 questionnaires) – assessed from enrollment in the study to 2 years after completion of the treatment

Source: https://euclinicaltrials.eu/ctis-public/view/2023-504699-73-00